EU clinical trial 2022-500685-10-00: An Open-label Study to check Safety, Tolerability and medication behaviour of a capsule with AZD6244 in Patients with Advanced Solid Malignancies
Protocol code: D1532C00005
Sponsor: Astrazeneca AB (Pharmaceutical company). Phase: Human Pharmacology (Phase I)- Other. Countries: Netherlands (ongoing, recruitment ended).
Therapeutic area(s): Diseases [C] - Neoplasms [C04]
Gender: Female, Male. Age: 18-64 years. Enrolment: 1.
Status: Ongoing, recruitment ended. Start date (EU): 2007-02-28. Decision date: 2022-07-28. Results received: No. Last updated: 2024-09-19.

Condition(s): Advanced solid malignancies

Source: https://euclinicaltrials.eu/ctis-public/view/2022-500685-10-00